EU clinical trial 2025-522475-28-00: A Phase 3, Double-Blind, Randomized, Placebo-Controlled Study of Levosimendan in Pulmonary Hypertension Patients with Heart Failure with Preserved Left Ventricular Ejection Fraction
Protocol code: TNX-103-07
Sponsor: Tenax Therapeutics Inc. (Pharmaceutical company). Phase: Therapeutic confirmatory (Phase III). Countries: France (authorised, recruitment pending), Italy (authorised, recruitment pending), Germany (authorised, recruitment pending), Czechia (authorised, recruitment pending), Austria (ongoing, recruiting), Poland (ongoing, recruiting), Hungary (ongoing, recruiting), Bulgaria (ongoing, recruiting), Spain (ongoing, recruiting).
Therapeutic area(s): Diseases [C] - Cardiovascular Diseases [C14]
Gender: Female, Male. Age: 18-64 years, 65+ years. Enrolment: 319.
Start date (EU): 2026-05-18. Decision date: 2026-03-24. Results received: No. Last updated: 2026-07-17.
Decision dates by country: PL: 2026-05-26, AT: 2026-03-30, BG: 2026-04-02, DE: 2026-03-27, ES: 2026-03-26, FR: 2026-04-16, CZ: 2026-05-12, HU: 2026-06-04, IT: 2026-03-25

Condition(s): Pulmonary Hypertension (PH) with Heart Failure with preserved left ventricular ejection fraction (PH-HFpEF)
Product: Levosimendan, The levosimendan placebo drug product is an immediate-release dosage form for oral administration.

Primary endpoint: Efficacy: Change from baseline in 6-MWD (Day 1 to Week 26). Safety: Incidence of AEs, SAEs, physical examinations, vital signs, clinical laboratory values, ECGs, heart rate and rhythm as determined by cardiac monitoring and AESI (Day 1 to Week 26)
Endpoint(s): 1. Change in KCCQ-TSS (Day 1 to Week 26)., 2. Number of Clinical Worsening Events (Day 1 to Week 26). Clinical Worsening Events are defined as: a. Unplanned hospitalization due to a cardiopulmonary indication OR Urgent outpatient visits for the administration of IV diuretics. b. Deaths (caused by clinical conditions directly related to cardiovascular events)., 3. Time to first occurrence of a Clinical Worsening Event (Day 1 to Week 26)., 4. Change in NYHA Functional Class (Day 1 to Week 26).

Source: https://euclinicaltrials.eu/ctis-public/view/2025-522475-28-00